EU clinical trial 2025-520675-86-00: A Phase 2b, Randomized, Blinded Trial Investigating the Efficacy and Safety of Visugromab in combination with Nivolumab and Lenvatinib compared to Double Placebo and Lenvatinib in Participants with Unresectable or Metastatic Hepatocellular Carcinoma and Compensated Liver Function (Child-Pugh A) after Failure of First-Line Treatment that Included an Anti-PD-(L)1 Compound (GDFATHER-HCC-01)
Protocol code: CTL-002-005
Sponsor: CatalYm GmbH (Pharmaceutical company). Phase: Therapeutic exploratory (Phase II). Countries: Germany (ongoing, recruiting), France (authorised, recruitment pending), Italy (ongoing, recruiting), Spain (ongoing, recruiting).
Therapeutic area(s): Diseases [C] - Neoplasms [C04]
Gender: Female, Male. Age: 18-64 years, 65+ years. Enrolment: 59.
Start date (EU): 2026-03-10. Decision date: 2025-12-23. Results received: No. Last updated: 2026-07-09.
Decision dates by country: ES: 2026-01-09, FR: 2026-01-05, IT: 2026-01-08, DE: 2025-12-23

Condition(s): Unresectable or Metastatic Hepatocellular Carcinoma and Compensated Liver Function (Child-Pugh A)
Product: NIVOLUMAB, LENVATINIB, Visugromab (CTL-002), SODIUM CHLORIDE

Primary endpoint: 1. Progression-free survival (PFS) as assessed by the local site. PFS is defined as time from randomization (during Safety Run-In: initiation of treatment) to first documented disease progression per RECIST v1.1 or death due to any cause, whichever occurred first.
Endpoint(s): 1. Independently assessed Progression-free survival by Blinded Independent Central Review, 2. Overall survival., 3. Objective response rate, defined as the percentage of participants with best overall response of complete response or partial response per RECIST v1.1 as assessed by the Investigator., 4. Participant weight course over time., 5. Complete response rate., 6. Partial response rate., 7. Objective response rate., 8. Time to response., 9. Duration of response., 10. Progression-free survival rate., 11. Overall survival rate., 12. Incidence, type, and severity of adverse events (AEs), recorded as treatment-emergent AEs (TEAEs), treatment-related AEs (including immune mediated Adverse Events [imAEs], reported as AEs of Special Interest [AESIs]), and serious AEs (SAEs)., 13. Participants’ subjective wellbeing as assessed via the European Organization for Research and Treatment of Cancer quality-of-life questionnaire for cancer (EORTC QLQ–C30).

Source: https://euclinicaltrials.eu/ctis-public/view/2025-520675-86-00